EU clinical trial 2022-503145-22-00: A two part, randomized, double-blind, placebo-controlled, parallel group SAD and MD clinical study to evaluate the safety, tolerability and preliminary efficacy of an inhaled (nebulized) phage cocktail in healthy subjects and in patients with chronic colonization of the lung with Pseudomonas aeruginosa
Protocol code: Phage4Cure-001
Sponsor: Charite Research Organisation GmbH (Pharmaceutical company). Phase: Human Pharmacology (Phase I)- First administration to humans. Countries: Germany (not authorised).
Therapeutic area(s): Diseases [C] - Respiratory Tract Diseases [C08]; Diseases [C] - Bacterial Infections and Mycoses [C01]
Gender: Female, Male. Age: 18-64 years. Enrolment: 32.
Status: Not authorised. Decision date: 2023-07-07. Results received: No. Last updated: 2023-07-07.

Condition(s): Pseudomonas colonization

Source: https://euclinicaltrials.eu/ctis-public/view/2022-503145-22-00